EU clinical trial 2023-505426-34-01: Mepolizumab and in-office nasal polypectomy in patients with chronic rhinosinusitis (CRS). A three arm study.
Protocol code: MELYSA
Sponsor: Instituto De Investigacion Marques De Valdecilla (Laboratory/Research/Testing facility). Phase: Therapeutic use (Phase IV). Countries: Spain (ongoing, recruiting).
Therapeutic area(s): Diseases [C] - Otorhinolaryngologic Diseases [C09]
Gender: Female, Male. Age: 18-64 years, 65+ years. Enrolment: 75.
Status: Ongoing, recruiting. Start date (EU): 2023-12-18. Decision date: 2023-10-20. Results received: No. Last updated: 2025-11-14.

Condition(s): chronic rhinosinusitis (CRS)
Product: Nucala 100 mg solution for injection in pre-filled syringe

Primary endpoint: SINO-NASAL OUTCOME TEST (SNOT-22)
Endpoint(s): VAS score for nasal symptoms, The following measurement will be assessed using a nasopharyngoscope: 1. CRSwNP: Lund-Kennedy scale 2. CRSwNP: Meltzer scale, Need of rescue therapy with systemic corticosteroids: dose, route of administration, length of treatment, number of treatments., Need of rescue surgery (either in-office polypectomy or full endoscopic sinus surgery), The resected polyp in the polypectomy groups will be sent for histology to confirm that it is eosinophilic and to obtain evidence of type 2 inflammation (tissue eos> 10/hpf), The safety of the treatment will be assessed by collecting Adverse Events at each of the study visits.

Source: https://euclinicaltrials.eu/ctis-public/view/2023-505426-34-01